EU clinical trial 2025-520689-23-00: Towards improved therapy selection and targeted treatment for nasopharyngeal carcinoma. A proof-of-concept pilot study for somatostatin receptor 2 imaging with [68Ga]Ga-DOTA-TOC PET/CT: the NACASOR trial
Protocol code: 21477
Sponsor: Universitair Medisch Centrum Groningen (Hospital/Clinic/Other health care facility). Phase: Phase I and Phase II (Integrated)- Other. Countries: Netherlands (ongoing, recruiting).
Therapeutic area(s): Diseases [C] - Neoplasms [C04]
Gender: Female, Male. Age: 18-64 years, 65+ years. Enrolment: 10.
Status: Ongoing, recruiting. Start date (EU): 2025-09-22. Decision date: 2025-07-14. Results received: No. Last updated: 2025-07-14.

Condition(s): nasopharyngeal carcinoma
Product: 68Ga-Dotatoc

Primary endpoint: [68Ga]Ga-DOTA-TOC PET imaging is considered feasible in patients with EBV related NPC if we can visualize and quantify tumor [68Ga]Ga-DOTA-TOC uptake in at least seven out of ten patients and complete repeat imaging in at least six patients.
Endpoint(s): SUVpeak values of primary tumors and lymph node metastases on the pre-treatment scan., SUVmean values in normal tissues and organs. Healthy lymph nodes will be defined as SUVpeak., Tumor SSTR2 expression determined by IHC.

Source: https://euclinicaltrials.eu/ctis-public/view/2025-520689-23-00